EU clinical trial 2025-521987-37-00: A Randomised, Double-blind, Multi-centre, Placebo-controlled, Crossover Study to Assess the Effect of Budesonide/Glycopyrronium/Formoterol Fumarate Metered Dose Inhaler on Cardiac and Lung Function in Participants with Chronic Obstructive Pulmonary Disease and Hyperinflation (ORATOS)
Protocol code: D5980C00048
Sponsor: AstraZeneca AB (Pharmaceutical company). Phase: Therapeutic use (Phase IV). Countries: Germany (ongoing, recruiting).
Therapeutic area(s): Diseases [C] - Respiratory Tract Diseases [C08]
Gender: Female, Male. Age: 18-64 years, 65+ years. Enrolment: 20.
Status: Ongoing, recruiting. Start date (EU): 2025-11-06. Decision date: 2025-09-15. Results received: No. Last updated: 2026-04-24.
Decision dates by country: DE: 2025-10-08

Condition(s): Chronic Obstructive Pulmonary Disease
Product: The placebo MDI is formulated as a suspension of spray-dried porous particles (consisting of 1,2-distearoyl-sn-glycero-3-phosphocholine [DSPC] and calcium chloride) in a hydrofluoroalkane propellant (HFA-134a). The placebo MDI uses the same excipients as active product but with absence of the active pharmaceutical ingredient (API)., Trixeo Aerosphere 5 micrograms/7.2 micrograms/160 micrograms pressurised inhalation, suspension

Primary endpoint: Change from baseline in left ventricular end diastolic volume (LVEDVi) measured by magnetic resonance imaging (MRI).
Endpoint(s): Change from baseline in functional residual capacity/total lung capacity (FRC/TLC) measured by body plethysmography., Change from baseline in residual volume/total lung capacity (RV/TLC) measured by body plethysmography

Source: https://euclinicaltrials.eu/ctis-public/view/2025-521987-37-00